EU clinical trial 2022-501717-31-00: Effect of intravenous immunoglobulins on painful sensory neuropathy evaluated by aggregated N-of-one trials
Sponsor: Sorlandet Sykehus HF (Hospital/Clinic/Other health care facility). Phase: Phase II and Phase III (Integrated). Countries: Norway (authorised, recruitment pending).
Therapeutic area(s): Diseases [C] - Nervous System Diseases [C10]
Gender: Female, Male. Age: 18-64 years. Enrolment: 30.
Status: Authorised, recruitment pending. Decision date: 2022-12-09. Results received: No. Last updated: 2026-02-26.

Condition(s): Idiopathic painful small fiber neuropathy or sensory neuronopathy.
Product: Privigen 100 mg/ml solution for infusion, Natriumklorid Fresenius Kabi 9 mg/ml infusjonsvæske, oppløsning, Saline 0.9%

Primary endpoint: Pain intensity the second week (mean of days 8, 10 and 13) after start of IVIG/placebo infusions scored on a numeric rating scale (NRS) ranging from 0 to 10
Endpoint(s): Pain intensity across 4 weeks after start of each infusion (mean of scoring three times per week from day 8 to 34), Disability and quality of life at the end of the third week after infusion scored on: Polyneuropathy Patient-reported Index (CAPPRI), Anti-FGF3 antibodies, Adverse events

Source: https://euclinicaltrials.eu/ctis-public/view/2022-501717-31-00